EU clinical trial 2023-505378-14-00: Early Versus Postponed Supplementary Parenteral Nutrition After Major Emergency Abdominal Surgery: A Randomized, Controlled, Multicenter Study (the EATERS trial)
Sponsor: Herlev Hospital (Hospital/Clinic/Other health care facility). Phase: Therapeutic use (Phase IV). Countries: Denmark (ongoing, recruitment ended).
Therapeutic area(s): Diseases [C] - Digestive System Diseases [C06]
Gender: Female, Male. Age: 18-64 years, 65+ years. Enrolment: 342.
Status: Ongoing, recruitment ended. Start date (EU): 2023-10-18. Decision date: 2023-06-29. Results received: No. Last updated: 2026-05-24.

Condition(s): Major emergency abdominal surgery
Product: SmofKabiven, SmofKabiven Perifer

Primary endpoint: A reduction in rate of infectious complications during admission
Endpoint(s): Rate of complications during admission stratified by type and severity, Length of stay, 30-day mortality, 90-day mortality, Readmission rate and cause within 90 days, Energy and protein intake stratified by route, day, and amount during admission

Source: https://euclinicaltrials.eu/ctis-public/view/2023-505378-14-00